EU clinical trial 2023-508879-36-00: Master protocol of two randomized, double blind, placebo-controlled, multi-center, parallel group studies to evaluate the efficacy and safety of dupilumab in adult patients with chronic pruritus of unknown origin (CPUO)
Protocol code: EFC16973
Sponsor: Sanofi-Aventis Recherche & Developpement (Pharmaceutical company). Phase: Therapeutic confirmatory (Phase III). Countries: Hungary (ongoing, recruitment ended), Italy (ongoing, recruiting), Spain (ongoing, recruiting), Poland (ongoing, recruiting), Germany (ongoing, recruiting), France (ongoing, recruiting).
Therapeutic area(s): Diseases [C] - Immune System Diseases [C20]
Gender: Female, Male. Age: 18-64 years, 65+ years. Enrolment: 172.
Start date (EU): 2022-04-28. Decision date: 2024-02-23. Results received: No. Last updated: 2026-05-04.
Decision dates by country: PL: 2024-02-29, IT: 2024-02-26, ES: 2024-02-23, FR: 2025-11-03, HU: 2024-02-23, DE: 2024-02-26

Condition(s): Pruritus
Product: LORATADINE, FEXOFENADINE, Dupilumab, Matched placebo to test

Primary endpoint: Study A: Proportion of participants with improvement (reduction) in weekly average of daily worst-itch numerical rating scale (WI-NRS) by ≥4 from baseline to Week 24, Study B: Proportion of participants with improvement (reduction) in weekly average of daily WI-NRS by ≥4 from baseline to Week 12
Endpoint(s): Study A: Proportion of participants with improvement (reduction) in weekly average of daily WI-NRS by ≥4 from baseline to Week 12, Study A: Proportion of participants who scored “none” or “mild” in Patient Global Impression of Severity (PGIS) of pruritus at Week 24, Study A; Proportion of participants with improvement (reduction) in weekly average of daily WI-NRS by ≥4 from baseline over time until Week 24, Study A: Time to first response of WI-NRS ≥4 points reduction from baseline by Week 24, Study A: Absolute change from baseline in weekly average of daily WI-NRS at Week 24, Study A: Percent change from baseline in weekly average of daily WI-NRS at Week 24, Study A: Proportion of participants who scored “none” or “mild” in PGIS of pruritus at Week 12, Study A: Absolute change from baseline in weekly average of daily WI-NRS at Week 12, Study A: Percent change from baseline in weekly average of daily WI-NRS at Week 12, Study A: Absolute change from baseline in weekly average of daily sleep disturbances numerical rating scale (NRS) at Week 24, Study A: Percent change from baseline in weekly average of daily sleep disturbances NRS at Week 24, Study A: Change from baseline in Dermatology Life Quality Index (DLQI) score at Week 24, Study A: Change from baseline in the Itchy quality of life (ItchyQoL) score at Week 24, Study A: Change from baseline in Hospital Anxiety and Depression Scale (HADS) total score at Week 24, Study A: Absolute change from baseline in weekly average of daily sleep disturbances NRS at Week 12, Study A: Percent change from baseline in weekly average of daily sleep disturbances NRS at Week 12, Study A: Change from baseline in DLQI score at Week 12, Study A: Change from baseline in the ItchyQoL score at Week 12, Study A: Change from baseline in HADS total score at Week 12, Study A: Percentage of participants experiencing treatment-emergent adverse events (TEAEs) or serious adverse events (SAEs) from baseline through end of study (EOS), Study A: Incidence of treatment-emergent antidrug antibodies (ADA) against dupilumab, Study B: Proportion of participants who scored “none” or “mild” in PGIS of pruritus at Week 24, Study B: Proportion of participants who scored “none” or “mild” in PGIS of pruritus at Week 12, Study B: Absolute change from baseline in weekly average of daily WI-NRS at Week 12, Study B: Percent change from baseline in weekly average of daily WI-NRS at Week 12, Study B: Absolute change from baseline in weekly average of daily WI-NRS at Week 24, Study B: Percentage change from baseline in weekly average of daily WI-NRS at Week 24, Study B: Proportion of participants with improvement (reduction) in weekly average of daily WI-NRS by ≥4 from baseline, sustained from Week 19 through Week 24, Study B: Proportion of participants with improvement (reduction) in weekly average of daily WI-NRS by ≥5 from baseline to Week 24, Study B: Proportion of participants with improvement (reduction) in weekly average of daily WI-NRS by ≥4 from baseline to Week 24, Study B: Proportion of participants with weekly average of daily WI-NRS <2 at Week 24, Study B: Time to first response of WI-NRS ≥4 points reduction from baseline by Week 24, Study B: Proportion of participants with improvement (reduction) in weekly average of daily WI-NRS by ≥5 from baseline to Week 12, Study B: Proportion of participants with weekly average of daily WI-NRS <2 at Week 12, Study B: Absolute change from baseline in weekly average of daily itch-related sleep disturbance NRS at Week 12 and Week 24, Study B: Percent change from baseline in weekly average of daily itch-related sleep disturbance NRS at Week 12 and Week 24, Study B: Change from baseline in DLQI score at Week 12 and Week 24, Study B: Change from baseline in the ItchyQoL score at Week 12 and Week 24, Study B: Change from baseline in HADS total score at Week 12 and Week 24, Study B: Percentage of participants experiencing TEAEs or SAEs from baseline through EOS, Study B: Incidence of treatment-emergent ADA against dupilumab

Source: https://euclinicaltrials.eu/ctis-public/view/2023-508879-36-00